EU clinical trial 2024-518529-14-00: A Phase I/IIa study of intra-tumoral BT-001 (TG6030) administered alone, and in combination with pembrolizumab in patients with cutaneous or, subcutaneous lesions or, easily injectable lymph nodes of metastatic/advanced solid tumors.
Protocol code: BT-001.01
Sponsor: Transgene (Pharmaceutical company). Phase: Phase I and Phase II (Integrated)- First administration to humans. Countries: Belgium (ended), France (ended).
Therapeutic area(s): Diseases [C] - Neoplasms [C04]
Gender: Female, Male. Age: 18-64 years, 65+ years. Enrolment: 30.
Status: Ended. Start date (EU): 2021-02-26. End date (EU): 2025-10-22. Decision date: 2024-12-04. Results received: No. Last updated: 2025-08-26.
Decision dates by country: FR: 2024-12-04, BE: 2024-12-06

Condition(s): Metastatic/advanced soft tissue sarcoma (STS), Merkel cell carcinoma (MCC), melanoma, triple negative breast cancer (TNBC) or non-small cell lung cancer (NSCLC).
Product: PEMBROLIZUMAB, BT-001, TG6030, Vaccinia Immunoglobulin Intravenous (Human) [VIGIV]

Primary endpoint: Phase I part: Overall incidence of AEs and DLTs, SAEs, Phase IIa part - Soft Tissue Sarcoma cohort: Progression Free Rate at 6-months according to iRECIST, Phase IIa part - All cohorts except Soft Tissue Sarcoma : Immune Overall Response Rate according to iRECIST.
Endpoint(s): Overall incidence of AEs and DLTs, SAEs (Phase IIa part), Disease Control rate overall and at 4-month using RECIST 1.1 and iRECIST, Progression Free Survival using RECIST 1.1 and iRECIST, Overall Survival

Source: https://euclinicaltrials.eu/ctis-public/view/2024-518529-14-00